EU clinical trial 2023-508992-35-00: A Phase 2b Multicenter, Randomized, Double-blind, Placebo-controlled Dose-Ranging Study to Evaluate the Efficacy and Safety of JNJ-81241459 for the Treatment of Participants with Moderate to Severe Plaque Psoriasis
Sponsor: Janssen Cilag International (Pharmaceutical company). Phase: Therapeutic exploratory (Phase II). Countries: France (ended), Spain (ended), Poland (ended), Germany (ended).
Therapeutic area(s): Diseases [C] - Immune System Diseases [C20]
Gender: Female, Male. Age: 18-64 years, 65+ years. Enrolment: 100.
Status: Ended. End date (EU): 2024-06-21. Decision date: 2024-05-07. Results received: Yes. Last updated: 2024-05-13.
Decision dates by country: FR: 2024-05-13, DE: 2024-05-08, ES: 2024-05-07, PL: 2024-05-07

Condition(s): Plaque Psoriasis
Product: JNJ-81241459, JNJ-81241459 200mg, placebo tablet, JNJ-81241459, JNJ-81241459 50mg, placebo tablet

Primary endpoint: PASI 75 at Week 12

Source: https://euclinicaltrials.eu/ctis-public/view/2023-508992-35-00